EU clinical trial 2025-520843-34-00: Efficacy of Ketamine for the Prevention of Relapse in Patients with Opioid-Use Disorders (OUD)
Protocol code: EXCELLENCE/0421/0543
Sponsor: University of Cyprus (Educational Institution). Phase: Therapeutic exploratory (Phase II). Countries: Cyprus (authorised, recruitment pending).
Therapeutic area(s): Diseases [C] - Nervous System Diseases [C10]
Gender: Female, Male. Age: 18-64 years, 65+ years. Enrolment: 20.
Status: Authorised, recruitment pending. Decision date: 2025-01-29. Results received: No. Last updated: 2026-02-17.

Condition(s): Opioid Use Disorder
Product: KETAMINE

Primary endpoint: Reversal of comorbid negative affective behaviors, Prolongation/maintenance of abstinence in OUD patients, Reduction in cravings
Endpoint(s): Identification of predictive biomarkers: (i) Emotion regulation ability; (ii) Stress response biomarkers; (iii) Changes in neural activity, Association between ketamine-induced changes in brain activity and treatment outcomes

Source: https://euclinicaltrials.eu/ctis-public/view/2025-520843-34-00